EU clinical trial 2023-506062-31-01: Comparison of different doses of perineural dexmedetomidine as adjuvans to ropivacaine 0,67% for interscalene plexus block in association with 10 mg intravenous dexamethasone: a single center, double blinded, randomised controlled trial.
Protocol code: azr2023001
Sponsor: Algemeen ziekenhuis Rivierenland (Health care). Phase: Phase III and phase IV (Integrated). Countries: Belgium (ended).
Therapeutic area(s): Diseases [C] - Musculoskeletal Diseases [C05]
Gender: Female, Male. Age: 18-64 years, 65+ years. Enrolment: 260.
Status: Ended. Start date (EU): 2024-01-02. End date (EU): 2025-06-20. Decision date: 2023-11-09. Results received: No. Last updated: 2023-11-09.

Condition(s): Patients scheduled for shoulder operations
Product: Natriumklorid B. Braun 9 mg/ml innrennslislyf, lausn, Ropivacaine 7.5 mg / ml solution for injection, Dexdor 100 micrograms/ml concentrate for solution for infusion, Dexamethason CF 20 mg/ml, injectievloeistof

Primary endpoint: Length of analgesia ( time untill intake of analgeticum )
Endpoint(s): Lenght of sensoric block, Length of motoric block, Percentage of postoperative nausea and vomiting first 48 hours, Time to recovery after anesthesia, Percentage of side effects during anesthesia ( hypotension, bradycardia ), Numeric Rating Scale score for pain the first 48 hours, Cumulative opioid consumption over 48 hours

Source: https://euclinicaltrials.eu/ctis-public/view/2023-506062-31-01